EU clinical trial 2024-514588-24-00: A Modular, Multipart, Multi-arm, Open-label, Phase I/IIa Study to Evaluate the Safety and Tolerability of EP0042 Alone and in Combination with Anti-cancer Treatments in Patients with Advanced Malignancies.
Protocol code: EP0042-101
Sponsor: Ellipses Pharma Limited (Pharmaceutical company). Phase: Phase I and Phase II (Integrated)- First administration to humans. Countries: Netherlands (temporarily halted).
Therapeutic area(s): Diseases [C] - Neoplasms [C04]
Gender: Female, Male. Age: 18-64 years, 65+ years. Enrolment: 13.
Status: Temporarily halted. Start date (EU): 2021-09-27. Decision date: 2024-08-06. Results received: No. Last updated: 2025-05-06.

Condition(s): Acute Myeloid Leukaemia (AML), Myelodysplastic Syndrome (MDS), Chronic Myelomonocytic Leukemia (CMML)
Product: Vidaza 25 mg/ml powder for suspension for injection, Venclyxto 100 mg film-coated tablets, Venclyxto 10 mg film-coated tablets, Venclyxto 50 mg film-coated tablets, Venclyxto 10 mg film-coated tablets, Venclyxto 50 mg film-coated tablets, Venclyxto 100 mg film-coated tablets, Venclyxto 100 mg film-coated tablets

Primary endpoint: Module 1 Primary Endpoints: 1. Incidence of DLT, adverse events (AEs), serious adverse events (SAEs) and changes in laboratory parameters, physicalexamination, vital signs and electrocardiograms (ECGs)., Module 2 Primary Endpoints: 1. Incidence of DLTs, AEs, SAEs and changes in laboratory parameters, physical examination, vital signs and electrocardiograms.
Endpoint(s): Module 1 Secondary Endpoints: 1. Plasma PK parameters (AUClast, AUCinf, Cmax and/or Cmin, Tmax, t1/2, CL/F, V/F and/or Vz/F) after single and multiple doses 2. Best overall response (BOR) 3. Duration of response (DOR) 4. Overall survival (OS), Module 2 Secondary Endpoints: 1. Plasma PK parameters (AUClast, AUCinf, Cmax and/or Cmin, Tmax, t1/2, CL/F, V/F and/or Vz/F) of EP0042 and combinationagents after single and multiple doses. 2. BOR 3. DOR 4. Event free survival (EFS) 5. RFS 6. OS

Source: https://euclinicaltrials.eu/ctis-public/view/2024-514588-24-00